EU clinical trial 2024-514454-75-00: Mass Balance Study of [14C] ABBV-932 in Healthy Male Volunteers
Protocol code: M24-991
Sponsor: AbbVie Deutschland GmbH & Co. KG (Pharmaceutical company). Phase: Human Pharmacology (Phase I)- Other. Countries: Netherlands (ongoing, recruitment ended).
Therapeutic area(s): Phenomena and Processes [G] - Metabolism [G03]
Gender: Male. Age: 18-64 years. Enrolment: 8.
Status: Ongoing, recruitment ended. Start date (EU): 2026-04-16. Decision date: 2025-04-25. Results received: No. Last updated: 2026-06-11.

Condition(s): Healthy Volunteers

Source: https://euclinicaltrials.eu/ctis-public/view/2024-514454-75-00